EU clinical trial 2023-505499-32-00: A Randomised, Double-Blind, Placebo-Controlled, Parallel Group Study to Assess the Efficacy and Safety of Baxdrostat in Participants with Uncontrolled Hypertension on Two or More Medications including Participants with Resistant Hypertension
Protocol code: BaxHTN / D6970C00002
Sponsor: Astrazeneca AB (Pharmaceutical company). Phase: Therapeutic confirmatory (Phase III). Countries: Netherlands (ended), Bulgaria (ended), Denmark (ended), Czechia (ended), Hungary (ended), France (ended), Germany (ended), Belgium (ended), Spain (ended), Austria (ended), Slovakia (ended), Italy (ended), Sweden (ended), Poland (ended).
Therapeutic area(s): Diseases [C] - Cardiovascular Diseases [C14]
Gender: Female, Male. Age: 18-64 years, 65+ years. Enrolment: 205.
Status: Ended. Start date (EU): 2024-03-08. End date (EU): 2025-10-07. End date: 2025-10-10. Decision date: 2024-02-16. Results received: No. Last updated: 2025-08-25.
Decision dates by country: AT: 2024-02-26, BG: 2024-02-26, BE: 2024-02-16, HU: 2024-02-21, FR: 2024-02-20, ES: 2024-02-19, SK: 2024-02-22, PL: 2024-05-15, DK: 2024-02-19, SE: 2024-05-15, NL: 2024-02-26, DE: 2024-02-21, IT: 2024-03-04, CZ: 2024-02-20

Condition(s): Uncontrolled hypertension (uTHN) defined as blood pressure that remains higher than goal levels despite patients being treated with 2 anti-hypertensive agents, including a diuretic. Resistant hypertension (rHTN) defined as blood pressure that remains higher than goal levels despite the use of at least 3 anti hypertensive drugs of different classes at maximum tolerated dose, including a diuretic.
Product: Baxdrostat, Baxdrostat Placebo, Baxdrostat

Primary endpoint: Change from baseline in seated systolic blood pressure for 2 mg baxdrostat., Change from baseline in seated systolic blood pressure for 1 mg baxdrostat., Safety and tolerability will be evaluated in terms of AEs, vital signs, clinical and laboratory assessments.
Endpoint(s): Change from randomised withdrawal baseline (Week 24) in seated systolic blood pressure (SBP) for 2 mg baxdrostat., Change from baseline in seated SBP for 2 mg baxdrostat., Change from baseline in seated diastolic blood pressure (DBP) for 2 mg baxdrostat., Achieving seated SBP < 130 mmHg for 2 mg baxdrostat., Change from baseline in seated SBP for 1 mg baxdrostat., Change from baseline in seated DBP for 1 mg baxdrostat., Achieving seated SBP < 130 mmHg for 1 mg baxdrostat.

Source: https://euclinicaltrials.eu/ctis-public/view/2023-505499-32-00